EU clinical trial 2024-514401-54-00: A Phase 3, Randomized, Double-blind, Placebo-controlled Study to Evaluate Efficacy and Safety of Mezagitamab Subcutaneous Injection in Participants with Chronic Primary Immune Thrombocytopenia
Protocol code: TAK-079-3002
Sponsor: Takeda Development Center Americas Inc. (Pharmaceutical company). Phase: Therapeutic confirmatory (Phase III). Countries: Poland (ongoing, recruiting), Spain (ongoing, recruiting), Bulgaria (ongoing, recruiting), Italy (ongoing, recruiting), Netherlands (ongoing, recruiting), Croatia (authorised, recruitment pending), Germany (authorised, recruitment pending), Sweden (authorised, recruiting), Greece (ongoing, recruiting), Czechia (authorised, recruitment pending), Norway (authorised, recruiting), France (authorised, recruitment pending).
Therapeutic area(s): Diseases [C] - Hemic and Lymphatic Diseases [C15]
Gender: Female, Male. Age: 18-64 years, 65+ years. Enrolment: 101.
Start date (EU): 2025-11-13. Decision date: 2025-10-22. Results received: No. Last updated: 2026-03-30.
Decision dates by country: ES: 2025-10-24, NL: 2025-10-24, BG: 2025-10-23, PL: 2025-10-26, HR: 2026-03-30, DE: 2026-03-16, SE: 2026-03-11, GR: 2026-02-16, CZ: 2026-03-09, NO: 2026-03-19, FR: 2026-03-27, IT: 2025-10-22

Condition(s): Chronic Primary Immune Thrombocytopenia
Product: Mezagitamab, Placebo matching for Mezagitamab

Primary endpoint: Durable platelet response through Week 24, defined as platelet count ≥50,000/μL on at least 4 of the 6 weekly platelet measurements between Week 19 and Week 24.
Endpoint(s): 1. The cumulative number of weeks that a platelet count was ≥50,000/μL through Week 24., 2. Time to first platelet count ≥50,000/µL., 3. The cumulative number of weeks that a platelet count was ≥30,000/μL through Week 24 and at least doubled from baseline., 4. Complete platelet response, defined as a platelet count ≥100,000/µL on at least 2 visits through Week 24., 5. Platelet response at Week 16, defined as a platelet count ≥50,000/µL before IMP administration at the Week 16 visit., 6. Change from baseline in the Symptoms scale score of the ITP-PAQ at Week 16., 7. Change from baseline in the Symptoms scale score of the ITP-PAQ at Week 24., 8. Occurrence of receiving rescue therapy., 9. Time to first rescue therapy., 10. Presence of bleeding events, defined as Grade ≥2 in the Skin domain, or Grade ≥1 in the Mucosal domain, or Grade ≥1 in the Organ domain, in the ITP-BAT through Week 24., 11. The serum concentration of mezagitamab during and after intervention., 12. Incidence of ADA and change in ADA titers., 13. Incidence of neutralizing ADA.

Source: https://euclinicaltrials.eu/ctis-public/view/2024-514401-54-00